EU clinical trial 2023-510258-17-00: Phase IIa Proof-of-Concept Study, with Dose-Titration Based on Treat-to-Target Strategy, to Investigate the Efficacy, Safety, and Tolerability of Subcutaneous Injection of Folate-based Liposomes Encapsulating Methotrexate (FBL-MTX) in Disease-modifying Antirheumatic Drugs (DMARD)-naïve Patients with Moderate-to-Severe Active Rheumatoid Arthritis and in Patients with an Inadequate Response or Intolerance to Oral MTX.
Protocol code: FBL-MTX-201
Sponsor: Solfarcos Solucoes Farmaceuticas E Cosmeticas Lda. (Pharmaceutical company). Phase: Therapeutic exploratory (Phase II). Countries: Portugal (ended).
Therapeutic area(s): Diseases [C] - Immune System Diseases [C20]; Diseases [C] - Musculoskeletal Diseases [C05]
Gender: Female, Male. Age: 18-64 years, 65+ years. Enrolment: 40.
Status: Ended. Start date (EU): 2024-07-24. End date (EU): 2026-07-20. Decision date: 2024-05-21. Results received: No. Last updated: 2026-08-03.

Condition(s): Rheumatoid arthritis (RA)
Product: Methotrexate

Primary endpoint: Change from baseline in Disease Activity Score (DAS) for 28-joint count using C-reactive protein (DAS28-CRP) at Week 14., Change from baseline in DAS28-CRP at Weeks 4, 8, and 12., Number of subjects who achieve remission (DAS28-CRP <2.6) at Weeks 4, 8, 12, and 14., Number of subjects who achieve low disease activity (DAS28-CRP <3.2) at Weeks 4, 8, 12, and 14., Number of subjects who achieve American College of Rheumatology (ACR) 20% (ACR20) response at Weeks 4, 8, 12, and 14., Number of subjects who achieve ACR50 response at Weeks 4, 8, 12, and 14., Number of subjects who achieve ACR70 response at Weeks 4, 8, 12, and 14., Change from baseline in Clinical Disease Activity Index (CDAI) at Weeks 4, 8, 12, and 14., Change from baseline in Simplified Disease Activity Index (SDAI) at Weeks 4, 8, 12, and 14., Change from baseline in Health Assessment Questionnaire - Disability Index (HAQ-DI) score at Weeks 4, 8, 12, and 14., Change from baseline in Medical Outcomes Study 36-Item Short Form Health Survey (SF-36) at Week 14.
Endpoint(s): Incidence of treatment-emergent adverse events (TEAEs) and serious adverse events (SAEs). Clinically relevant abnormalities in vital signs, 12-lead ECG, and laboratory parameters will be reported as AEs., Change from baseline at each scheduled time point of measurement in laboratory parameters (hematology and biochemistry)., Pharmacokinetic parameters: Cmax; Time of occurrence of Cmax; Time of observation prior to the first measurable (non-zero) drug concentration; Area under the concentration versus time curve (AUC) from time of dosing to the time of last measurable concentration; AUC extrapolated to infinity; Apparent terminal elimination rate constant; Apparent terminal elimination half-life; Apparent volume of distribution; and Apparent total body clearance., Change from baseline in DAS28-CRP every 4 weeks., Change in SF-36 every 4 weeks., Incidence of TEAEs and SAEs. Clinically relevant abnormalities in vital signs, 12-lead ECG and laboratory parameters will be reported as AEs.

Source: https://euclinicaltrials.eu/ctis-public/view/2023-510258-17-00